EU clinical trial 2024-514785-39-00: "Imaging with 68Ga-DOTA-peptides and peptide receptor radionuclide therapy with 177Lu-DOTA-peptides of gastroenteropancreatic neuroendocrine tumors: interest of intra-arterial hepatic infusion in patients with dominant liver metastases" "LUTARTERIAL"
Protocol code: CHUBX 2017/47
Sponsor: Centre Hospitalier Universitaire De Bordeaux (Hospital/Clinic/Other health care facility). Phase: Therapeutic exploratory (Phase II). Countries: France (ongoing, recruiting).
Therapeutic area(s): Analytical, Diagnostic and Therapeutic Techniques and Equipment [E] - Diagnosis [E01]; Analytical, Diagnostic and Therapeutic Techniques and Equipment [E] - Therapeutics [E02]
Gender: Female, Male. Age: 18-64 years, 65+ years. Enrolment: 23.
Status: Ongoing, recruiting. Start date (EU): 2021-09-24. Decision date: 2024-11-04. Results received: No. Last updated: 2024-11-04.

Condition(s): Gastroenteropancreatic neuroendocrine tumours (GEP-NETs) in adults
Product: HYDROXYZINE RENAUDIN 100 mg/2 mL, solution injectable, LysaKare 25 g/25 g solution for infusion, Lutathera 370 MBq/mL solution for infusion, XENETIX 350 (350 mg d’Iode/mL), solution injectable, IMODIUM 2 mg, gélule, ZOPHREN 8 mg, comprimé pelliculé, Galliad, 0,74 à 1,85 GBq, générateur radiopharmaceutique, SomaKit TOC 40 micrograms kit for radiopharmaceutical preparation, LASILIX 40 mg, comprimé sécable, GalliaPharm 0,74 – 1,85 GBq Radionuklidgenerator, AMLOR 10 mg, gélule

Primary endpoint: 68Ga-DOTA-peptides uptake (Maximum Standardized Uptake Value) in up to 5 liver metastases on PET-scan obtained after intra-hepatic injection
Endpoint(s): Safety profile : safety of 177Lu-DOTA-peptide after intra-arterial hepatic administration, 68Ga-DOTA-peptide uptake (SUVmax) on dose limiting organs (kidney, spleen, healthy liver, bone marrow) after 68Ga-DOTA-peptides by arterial intrahepatic and intravenous injections, 68Ga-DOTA-peptide uptake (SUVmax) on extra-hepatic lesion (if present) after 68Ga-DOTA-peptides by arterial intrahepatic and intravenous injections, Estimate the lesional and organ (kidney, spleen, healthy liver, bone marrow) absorbed doses after 177Lu-DOTA-peptide administration by intra-arterial hepatic and intravenous injections, Efficacy evaluation of the fifth cycle of 177Lu-DOTA-peptide therapy administered by intra-arterial hepatic infusion according to RECIST1.1 criteria

Source: https://euclinicaltrials.eu/ctis-public/view/2024-514785-39-00